EU clinical trial 2024-517546-33-00: CellThRPE1
Sponsor: St Erik Eye Hospital (Hospital/Clinic/Other health care facility). Phase: Human Pharmacology (Phase I)- First administration to humans. Countries: Sweden (authorised, recruitment pending).
Therapeutic area(s): Diseases [C] - Eye Diseases [C11]
Gender: Female, Male. Age: 18-64 years, 65+ years. Enrolment: 15.
Status: Authorised, recruitment pending. Decision date: 2025-06-05. Results received: No. Last updated: 2025-06-05.

Condition(s): Geographic atrophy secondary to dry age-related macular degeneration

Source: https://euclinicaltrials.eu/ctis-public/view/2024-517546-33-00